EU clinical trial 2024-512016-22-00: A Randomized, Open-Label, Phase 3 Study to Evaluate Efficacy and Safety of Pembrolizumab (MK-3475) plus Epacadostat vs Standard of Care (Sunitinib or Pazopanib) as First-Line Treatment for Locally Advanced or Metastatic Renal Cell Carcinoma (mRCC) (KEYNOTE-679/ECHO-302)
Protocol code: MK-3475-679
Sponsor: Incyte Corp. (Pharmaceutical company). Phase: Therapeutic confirmatory (Phase III). Countries: Spain (ended).
Therapeutic area(s): Diseases [C] - Neoplasms [C04]
Gender: Female, Male. Age: 18-64 years, 65+ years. Enrolment: 5.
Status: Ended. Start date (EU): 2017-12-27. End date (EU): 2025-06-04. End date: 2025-06-05. Decision date: 2024-04-15. Results received: Yes. Last updated: 2025-06-02.

Condition(s): Locally advanced/metastatic renal cell carcinoma
Product: Sutent 12.5 mg hard capsules, KEYTRUDA 25 mg/mL concentrate for solution for infusion, PAZOPANIB, Sutent 25 mg hard capsules

Primary endpoint: Objective Response Rate (ORR) of Pembrolizumab + Epacadostat Versus Standard of Care (SOC)
Endpoint(s): Safety and Tolerability of Pembrolizumab + Epacadostat Versus SOC as Measured by the Number of Participants Experiencing Adverse Events (AEs), Safety and Tolerability of Pembrolizumab + Epacadostat Versus SOC as Measured by the Number of Participants Discontinuing Study Drug Due to AEs

Source: https://euclinicaltrials.eu/ctis-public/view/2024-512016-22-00